EU clinical trial 2023-503293-21-00: Multicenter, Safety Follow-up Study to Assess Safety of Prior Treatment with Romosozumab in Children and Adolescents with Osteogenesis Imperfecta
Protocol code: 20220043
Sponsor: Amgen Inc. (Pharmaceutical company). Phase: Therapeutic confirmatory (Phase III). Countries: Germany (ongoing, recruiting), Hungary (authorised, recruitment pending), Italy (authorised, recruitment pending), Belgium (authorised, recruitment pending), Austria (authorised, recruitment pending), Slovakia (authorised, recruitment pending), Spain (authorised, recruitment pending).
Therapeutic area(s): Diseases [C] - Skin and Connective Tissue Diseases [C17]; Diseases [C] - Musculoskeletal Diseases [C05]; Diseases [C] - Congenital, Hereditary, and Neonatal Diseases and Abnormalities [C16]
Gender: Female, Male. Age: 0-17 years. Enrolment: 32.
Start date (EU): 2026-03-25. Decision date: 2026-02-23. Results received: No. Last updated: 2026-07-28.
Decision dates by country: AT: 2026-02-23, SK: 2026-02-24, IT: 2026-03-02, HU: 2026-02-26, ES: 2026-03-02, DE: 2026-02-25, BE: 2026-02-27

Condition(s): Osteogenesis Imperfecta
Product: EVENITY 105 mg solution for injection in pre-filled syringe, EVENITY 105 mg solution for injection in pre-filled pen, EVENITY 105 mg solution for injection in pre-filled syringe, EVENITY 105 mg solution for injection in pre-filled pen

Primary endpoint: Adverse events

Source: https://euclinicaltrials.eu/ctis-public/view/2023-503293-21-00